EU clinical trial 2024-516723-14-00: A multicenter, randomized, open-label, blinded-assessor, phase 4 study in patients with early rheumatoid arthritis to compare active conventional therapy versus three biologic treatments, and two de-escalation strategies in patients who respond to treatment.
Protocol code: NORD-STAR
Sponsor: Karolinska Institutet (Educational Institution). Phase: Therapeutic use (Phase IV). Countries: Iceland (authorised, recruitment pending), Denmark (authorised, recruitment pending), Norway (authorised, recruitment pending), Sweden (authorised, recruitment pending).
Therapeutic area(s): Diseases [C] - Musculoskeletal Diseases [C05]
Gender: Female, Male. Age: 18-64 years, 65+ years. Enrolment: 705.
Status: Authorised, recruitment pending. Decision date: 2024-11-12. Results received: No. Last updated: 2024-12-30.
Decision dates by country: DK: 2024-11-12, IS: 2024-12-30, SE: 2024-11-12, NO: 2024-11-14

Condition(s): Rheumatoid Arthritis
Product: HYDROXYCHLOROQUINE, ABATACEPT, AZATHIOPRINE, SULFASALAZINE, METHOTREXATE, Cimzia 200 mg solution for injection in pre-filled syringe, LEFLUNOMIDE, RoActemra 162 mg solution for injection in pre-filled syringe., RoActemra 20 mg/mL concentrate for solution for infusion, PREDNISOLONE, Triamcinolone Hexacetonide 20 mg/ml suspension for injection, METHOTREXATE

Primary endpoint: Treatment Part 1: The primary efficacy outcome is the proportion of patients in remission at week 24 from baseline according to CDAI. Treatment Part 1: The primary radiographic outcome is the progression of total Sharp van der Heijde score after 48 weeks from baseline. Treatment Part 2: The primary efficacy outcome is the proportion of patients in remission according to CDAI, at the time point 24 weeks after the dose was first reduced.

Source: https://euclinicaltrials.eu/ctis-public/view/2024-516723-14-00